EU clinical trial 2024-519239-40-01: Itraconazole (ITRA) with standard radiotherapy (RT) and temozolomide (TMZ) in patients with newly diagnosed glioblastoma multiforme (GBM) ITRA-RAD: Phase I Clinical Study
Protocol code: IIT-2024/01
Sponsor: Otto Von Guericke Universitaet Magdeburg (Educational Institution). Phase: Human Pharmacology (Phase I)- Other. Countries: Germany (ongoing, recruiting).
Therapeutic area(s): Not possible to specify
Gender: Female, Male. Age: 18-64 years, 65+ years. Enrolment: 15.
Status: Ongoing, recruiting. Start date (EU): 2025-04-07. Decision date: 2025-03-21. Results received: No. Last updated: 2026-04-07.

Condition(s): Glioblastom
Product: Itraconazol Aristo 100 mg Hartkapseln

Primary endpoint: Determination of the maximum tolerated dose (MTD) of ITRA administered concomitantly with standard treatment (RT and TMZ)

Source: https://euclinicaltrials.eu/ctis-public/view/2024-519239-40-01